EU clinical trial 2023-505454-18-00: A Phase III Study to Assess the Efficacy and Safety of NEXIUM for Maintenance of Healing of Erosive Esophagitis in Pediatric Patients 1 to 11 Years of Age
Protocol code: D9612C09998
Sponsor: Astrazeneca AB (Pharmaceutical company). Phase: Therapeutic confirmatory (Phase III). Countries: Greece (ongoing, recruitment ended), Spain (ended), Belgium (ended), Italy (ended), Lithuania (ongoing, recruitment ended), Portugal (ended).
Therapeutic area(s): Diseases [C] - Digestive System Diseases [C06]
Gender: Female, Male. Age: 0-17 years. Enrolment: 54.
Start date (EU): 2021-11-24. Decision date: 2024-04-08. Results received: No. Last updated: 2026-07-22.
Decision dates by country: GR: 2024-05-13, BE: 2024-04-12, PT: 2024-04-08, LT: 2024-05-08, ES: 2024-04-09, IT: 2024-04-11

Condition(s): Erosive Esophagitis
Product: Esomeprazole Magnesium, Esomeprazole Magnesium, NEXIUM 10 mg gastro-resistant granules for oral suspension, sachet

Primary endpoint: Maintenance phase: • Presence/absence of EE for all patients by assessment of EGD at the end of the 16-week maintenance phase, • Safety and tolerability will be evaluated in terms of AEs, vital signs, and clinical laboratory variables. Assessments related to AEs cover: • Occurrence/frequency • Relationship to IMP as assessed by the investigator • Intensity • Seriousness • Death • AEs leading to discontinuation of IMP Vital signs parameters include systolic and diastolic blood pressure, and pulse as well as body weight.
Endpoint(s): Healing phase: • Presence/absence of EE for all patients by assessment of EGD at the end of the 8-week healing phase, • The percentage of days without rescue medication during the 8-week healing phase, • Safety and tolerability will be evaluated in terms of AEs, vital signs, and clinical laboratory variables Assessments related to AEs cover: • Occurrence/frequency • Relationship to IMP as assessed by the investigator • Intensity • Seriousness • Death • AEs leading to discontinuation of IMP Vital signs parameters include systolic and diastolic blood pressure, and pulse as well as body weight., Maintenance phase: • The percentage of days without rescue medication during the 16-week maintenance phase

Source: https://euclinicaltrials.eu/ctis-public/view/2023-505454-18-00